EU clinical trial 2025-521565-27-00: A randomized, multicenter, multiple-dose, double-blind, placebo-controlled, parallel-group design, clinical endpoint bioequivalence study to evaluate the therapeutic equivalence and safety of fluticasone furoate and vilanterol inhalation powder 100 mcg/25 mcg (Sandoz) and BREO® ELLIPTA® (fluticasone furoate and vilanterol inhalation powder) 100 mcg/25 mcg (GlaxoSmithKline) in adult participants with asthma
Protocol code: SAN-1138
Sponsor: Sandoz Private Limited (Pharmaceutical company). Phase: Therapeutic confirmatory (Phase III). Countries: Poland (not authorised).
Therapeutic area(s): Diseases [C] - Respiratory Tract Diseases [C08]
Gender: Female, Male. Age: 18-64 years, 65+ years. Enrolment: 120.
Status: Not authorised. Decision date: 2025-09-22. Results received: No. Last updated: 2025-09-22.

Condition(s): Asthma
Product: Salbutamol Aldo-Unión 100 microgramos/dosis suspensión para inhalación en envase a presión, Inhalation powder with lactose monohydrate and magnesium stearate, BREO ELLIPTA, Fluticasone furoate and Vilanterol inhalation powder 100 mcg/25 mcg

Primary endpoint: FEV1 AUC0-24h on the first day of the treatment, FEV1 measured in the morning prior to the dosing of inhaled medications on the last day of the 4-week treatment period. Note: The primary endpoints will be baseline-adjusted (change from baseline).
Endpoint(s): Adverse events (including TEAEs, SAEs, and/or AEs leading to study medication/study discontinuation), vital signs, and physical examination findings.

Source: https://euclinicaltrials.eu/ctis-public/view/2025-521565-27-00